EU clinical trial 2025-522406-20-00: A Phase 1b/2, Multicenter, Randomized, Double-blind, Placebo-controlled Study to Investigate A) the Safety, Tolerability, Pharmacokinetics, and Pharmacodynamics of Multiple Ascending Doses of IM-101 in Adult Participants with Generalized Myasthenia Gravis, and B) the Efficacy and Safety of Treatment of IM-101 in Adult Participants with Generalized Myasthenia Gravis and Ocular Myasthenia Gravis
Protocol code: IM-101_MG_2.1
Sponsor: Immunabs Inc. (Pharmaceutical company). Phase: Phase I and Phase II (Integrated)- Other. Countries: Bulgaria (ongoing, recruiting), Poland (ongoing, recruiting), Spain (ongoing, recruiting), Italy (ongoing, recruiting).
Therapeutic area(s): Diseases [C] - Nervous System Diseases [C10]
Gender: Female, Male. Age: 18-64 years, 65+ years. Enrolment: 83.
Status: Ongoing, recruiting. Start date (EU): 2026-06-15. Decision date: 2026-02-18. Results received: No. Last updated: 2026-06-18.
Decision dates by country: IT: 2026-02-18, PL: 2026-02-22, ES: 2026-02-18, BG: 2026-02-18

Condition(s): Generalized Myasthenia Gravis and Ocular Myasthenia Gravis
Product: IM-101 120mg/mL, Infanrix hexa, Powder and suspension for suspension for injection. Diphtheria (D), tetanus (T), pertussis (acellular, component) (Pa), hepatitis B (rDNA) (HBV), poliomyelitis (inactivated) (IPV) and Haemophilus influenzae type b (Hib) conjugate vaccine (adsorbed)., Prevenar 13 suspension for injection pneumococcal polysaccharide conjugate vaccine (13-valent, adsorbed), 0.9% Sodium Chloride (Normal Saline), Bexsero suspension for injection in pre-filled syringe Meningococcal group B Vaccine (rDNA, component, adsorbed), Menveo powder and solution for solution for injection Meningococcal Group A, C, W-135 and Y conjugate vaccine

Primary endpoint: [Part A, Multiple Ascending Dose Cohorts] Incidence of TEAEs, including clinically significant changes in physical examinations or ECGs during study treatment [Part B, Expansion Cohorts] Incidence of TEAEs including clinically significant changes in physical examinations or ECGs during study treatment, [Part A, Multiple Ascending Dose Cohorts] Incidence of treatment-emergent SAEs [Part B, Expansion Cohorts] Incidence of SAEs during study treatment, [Part A, Multiple Ascending Dose Cohorts] Incidence of TEAEs leading to premature study intervention discontinuation [Part B, Expansion Cohorts] Incidence of AEs that led to premature discontinuation, [Part A, Multiple Ascending Dose Cohorts] Incidence of AESIs during study treatment period [Part B, Expansion Cohorts] Incidence of AESIs during study treatment period, [Part B, Expansion Cohorts] 1. gMG cohorts: Change from baseline to Week 16 in the MG-ADL total score 2. oMG cohort: Change from baseline to Week 16 in MGII ocular score
Endpoint(s): [Part A, Multiple Ascending Dose Cohorts] Incidence and prevalence of ADAs and NAb to IM-101 [Part B, Expansion Cohorts] Incidence and prevalence of ADAs and NAb of IM-101 over time, [Part A, Multiple Ascending Dose Cohorts] Changes from baseline in vital signs, laboratory assessments, and other safety variables [Part B, Expansion Cohorts] Changes from baseline in vital signs, laboratory assessments, and other safety variables, Part A; Serum PK IM-101, Cmax, tmax, AUC0-tau, Ctrough, CL, Vz, t1/2, ratio for Cmax & AUC0-tau Part B [gMG] 1.Change from baseline to wk16 in QMG total; MGC scale; MG-QoL15r 2. %age participants with MG-ADL ≥ 2-point & ≥ 3-point change at Wk16 3. %age participants with MSE; MG-ADL of 0 or 1 [oMG] 1.Change from baseline to Wk16 in MG-ADL ocular domain & MGII total score 2.Quantitative change from baseline to Wk16 in QMG total score [All]1.%age requiring rescue therapy over 16-wk treatment period, [Part A, Multiple Ascending Dose Cohorts] Obtain serum IM-101 concentration for modeling and simulation [Part B, Expansion Cohorts] CH50, AH50, and total C5 and free C5 at baseline and timepoints during and following treatment, [Part A, Multiple Ascending Dose Cohorts] CH50, AH50, and total C5 and free C5 at baseline and timepoints during and following treatment [Part B, Expansion Cohorts] 1. Serum IM-101 concentrations over the treatment period 2. Sparse sample collections to support population PK modeling and simulations

Source: https://euclinicaltrials.eu/ctis-public/view/2025-522406-20-00